EU clinical trial 2023-506420-93-00: POMREP - Efficacy and safety of zoledronate versus placebo on pain at week 12 in pediatric patients with chronic recurrent multifocal osteomyelitis resistant to non-steroidal anti-inflammatory drug
Sponsor: Assistance Publique Hopitaux De Paris (Hospital/Clinic/Other health care facility). Phase: Therapeutic exploratory (Phase II). Countries: France (authorised, recruitment pending).
Therapeutic area(s): Diseases [C] - Musculoskeletal Diseases [C05]
Gender: Female, Male. Age: 0-17 years. Enrolment: 30.
Status: Authorised, recruitment pending. Decision date: 2026-05-26. Results received: No. Last updated: 2026-05-26.

Condition(s): Chronic recurrent multifocal osteomyelitis (CRMO)
Product: ZOLEDRONIC ACID, PLACEBO OF ZOLEDRONIC ACID

Primary endpoint: Change in standardized pain score (0–10 scale) from baseline to week 12, assessed using an age-appropriate validated self-assessment scale on a 0–10 metric: the Faces Pain Scale–Revised (FPS-R, 0–10) for children aged ≥4 and <6 years, the pediatric visual analog scale (VAS, 0–10) for children aged ≥6 years who are able to do so, and the Numerical Rating Scale (NRS, 0–10) for children aged ≥8 years, depending on comprehension and feasibility.
Endpoint(s): Pain assessment will be performed at baseline and weeks 4, 24 and 36 by the patient, using the same age-appropriate validated scales as for the primary endpoint. A reduction of pain ≥30% from baseline will be considered as clinically meaningful improvement, and a reduction of ≥50% as substantial improvement, assessed at weeks 4, 12, 24 and 36. Clinical remission is defined as complete disappearance of pain with a pain score of 0, assessed at weeks 12, 24 and 36, NSAIDs consumption will be measured by the average number of days with NSAIDs intake in the last 3 months. Other pain killers’ intakes or corticosteroids will also be recorded. Patients will receive a diary to collect information about pain medications. The consumption of NSAIDs and other pain killers will be assessed at weeks 12, 24 and 36., Clinical signs will be compared between the two study groups at baseline, week 12, 24 and 36. The main clinical signs assessed during the physical exams of the patient will be: Pain on joint palpation / Arthritis / Spinal deformation / Extra-osseous manifestations: dermatologic manifestations (acne, palmoplantar pustulosis and psoriasis), synovitis, and inflammatory bowel disease / Staturo-ponderal growth and puberty, Assessment at baseline, week 12, 24 and 36 of inflammatory syndrome by clinicians using blood analyses to determine the frequency of children over the norm for: Rate of White Blood Cells (WBC> 10 000/mm3) / Rate of platelets (> 400 000/mm3) / Rate of C Reactive Protein (>5mg/l) / Sedimentation Rate (> 10mm) / And rate of pro-inflammatory cytokines, Disease activity will be assessed using the CNO Clinical Disease Activity Score (CNO CDAS), a composite score developed specifically for chronic nonbacterial osteomyelitis. The CNO CDAS includes the following three components: Patient (or parent) pain assessment on a 0–10 visual analog scale (VAS) / Patient (or parent) global assessment of disease activity on a 0–10 VAS / Clinician-reported count of clinically active CNO lesions (0 to 10), Radiological assessment on whole-body MRI evaluated at baseline, week 12, 24 and 36: number of unequivocal lesions, number of new lesions since the previous MRI, and mRINBO score (including change from baseline), Treatment response will be assessed using the PedCNO composite score at baseline, week 12, 24 and 36. Both PedCNO30 and PedCNO50 will be considered as secondary endpoints. PedCNO30 and PedCNO50 are defined as at least 30% and 50% improvement, respectively, in at least three out of five core set variables, with no more than one of the remaining variables deteriorating by more than 30% or 50%, respectively. / ESR / Number of radiological lesions / VAS physician / VAS patient/parents / CHAQ, Radiological remission, defined as MRI negativity (normalisation of MRI). Early remission will be assessed at week 12 and remission at week 24 and 36., Clinical and biological remission, defined as the complete disappearance of pain and inflammatory syndrome. Clinical and biological remission will be assessed at week 12, 24 and 36., Quality of life of children will be assessed at baseline and week 12, 24 and 36 using the PedSQL (Pediatric Quality of Life Inventory) questionnaire. It is a validated instrument with an international application designed to measure children’s health-related quality of life in four dimensions. The questionnaire will be completed by the child (self-report) if ≥ 8 years of age and by the parents (proxy-report) for younger children, with both reports collected when possible., School and parental absenteeism will be defined by the number of days of absence from school or work for every period of 12 weeks. It will be measured at baseline, week 12, 24 and 36, Tolerance of ZA is defined by the occurrence of flu-like symptoms, headache, hypophosphatemia, hypocalcaemia., Efficiency is defined as the incremental cost-effectiveness ratio in cost per quality-adjusted life-year gained.

Source: https://euclinicaltrials.eu/ctis-public/view/2023-506420-93-00